EU clinical trial 2025-520802-37-00: Impact of GLP1-RAs on inflammation and endothelial biomarkerS in Type 2 diABetes meLlitus patiEnts: STABLE-GLP1 trial.
Protocol code: STABLE-GLP1
Sponsor: Universita' Degli Studi Di Napoli Federico II (Educational Institution). Phase: Therapeutic use (Phase IV). Countries: Italy (authorised, recruitment pending).
Therapeutic area(s): Diseases [C] - Nutritional and Metabolic Diseases [C18]
Gender: Female, Male. Age: 18-64 years. Enrolment: 80.
Status: Authorised, recruitment pending. Decision date: 2025-09-09. Results received: No. Last updated: 2025-11-25.

Condition(s): Type 2 diabetes mellitus
Product: SEMAGLUTIDE, SEMAGLUTIDE, SEMAGLUTIDE

Primary endpoint: To evaluate the effects of semaglutide in addition to standard therapy on inflammatory biomarkers compared with standard therapy alone in T2DM patients without ASCVD or severe TOD but with SCORE2-Diabetes >=10%. Regarding this endopoint, the change in inflammatory biomarkers and biomarkers of endothelial function at follow-up compared to baseline will be evaluated in both treatment arms.
Endpoint(s): To retrospectively evaluate fat attenuation index (FAI) and characteristics of subclinical atherosclerotic coronary plaques at CTA in T2DM patients without history ASCVD or severe TOD but with SCORE2-Diabetes >=10%. Regarding this endpoint, data from CTA, performed according to clinical practice before enrollment, will be recorded. FAI and plaque characteristics, including coronary plaque burden, size and composition will be evaluated retrospectively., To correlate FAI and characteristics of subclinical atherosclerotic coronary plaques at CTA in T2DM patients without history ASCVD or severe TOD but with SCORE2-Diabetes ≥10% to biomarkers evaluated at baseline., To correlate FAI and characteristics of subclinical atherosclerotic coronary plaques at CTA to biomarkers evaluated at 52 weeks and to the occurrence of adverse events in T2DM patients without history ASCVD or severe TOD but with SCORE2-Diabetes >=10% in both treatment arms., To assess the safety and tolerability of semaglutide in addition to standard therapy compared with standard therapy alone in T2DM patients without ASCVD or severe TOD but with SCORE2-Diabetes >/=10%. Concerning this endpoint, incidence of adverse events, serious adverse events, and discontinuation rates will be recorded and analyzed in both treatment arms.

Source: https://euclinicaltrials.eu/ctis-public/view/2025-520802-37-00